EU clinical trial 2024-515214-41-00: Gemcitabine plus nab-PAclitaxel as switch maiNTEnance versus cONtinuation of modified FOLFIRINOX as first-line chemotherapy in patients with advanced pancreatic cancer: the PANThEON phase III Trial.
Protocol code: PANThEON
Sponsor: Fondazione GONO G.I. (Patient organisation/association). Phase: Therapeutic confirmatory (Phase III). Countries: Italy (ongoing, recruiting).
Therapeutic area(s): Diseases [C] - Neoplasms [C04]
Gender: Female, Male. Age: 18-64 years, 65+ years. Enrolment: 340.
Status: Ongoing, recruiting. Start date (EU): 2025-03-27. Decision date: 2025-01-16. Results received: No. Last updated: 2026-06-03.

Condition(s): advanced pancreatic cancer
Product: PACLITAXEL, GEMCITABINE, IRINOTECAN, FLUOROURACIL, OXALIPLATIN, CALCIUM LEVOFOLINATE

Primary endpoint: Overall survival (OS) i.e. the time from randomization to death or last follow-up for alive patients.
Endpoint(s): PFS, i.e. the time from randomization to disease progression or death from any cause TTF, i.e. time from randomization to discontinuation of treatment for any reason, including progressive disease, treatment toxicity and death., ORR, i.e. the percentage of patients achieving a complete (CR) or partial (PR) response, according to RECIST 1.1 criteria DCR, i.e. the percentage of patients achieving a complete (CR) or partial (PR) response or a stable disease (SD), according to RECIST 1.1 criteria., Quality of life (QoL), i.e. QoL will be estimated with EORTC QLQ-C30 and the modules PAN26, FA12, CAX24, COMU26 a will be performed with the EORTC QLQ INFO25, which is a valid self-reported instrument consisting of 25 questions. Communication between patients and professionals will be assessed with the EORT QLC COMU26., Toxicity, i.e. the percentage of patients experiencing a specific adverse event, according to National Cancer Institute Common Toxicity Criteria (version 5.0)., Proportion of patients not eligible to randomization, i.e. patients who started induction treatment but result not eligible due to i) clinical deterioration or treatment toxicity, ii) withdraw consent or iii) disease progression documented as best response, iv) other causes., Subsequent treatment line frequency, i.e. the percentage of patients who undergo a systemic treatment (excluding locoregional treatments or surgical treatment of unresectable disease) after progression to first line in both arms.

Source: https://euclinicaltrials.eu/ctis-public/view/2024-515214-41-00